EU clinical trial 2024-518706-41-01: Prognostic Performance of Quantitative Myocardial Perfusion Imaging Using H2[15O] Positron Emission Tomography in Coronary Artery Disease - The AQUA COR trial
Sponsor: Vaestra Goetalandsregionen (Hospital/Clinic/Other health care facility). Phase: Therapeutic confirmatory (Phase III). Countries: Sweden (authorised, recruitment pending).
Therapeutic area(s): Analytical, Diagnostic and Therapeutic Techniques and Equipment [E] - Diagnosis [E01]; Analytical, Diagnostic and Therapeutic Techniques and Equipment [E] - Therapeutics [E02]; Diseases [C] - Cardiovascular Diseases [C14]
Gender: Female, Male. Age: 18-64 years, 65+ years. Enrolment: 40000.
Status: Authorised, recruitment pending. Decision date: 2026-06-03. Results received: No. Last updated: 2026-06-03.

Condition(s): Cardiovascular disease
Product: Adenosin Life Medical 5 mg/ml, Injektions-/infusionsvätska, lösning., Rapiscan 400 microgram solution for injection, O15-Water

Primary endpoint: The primary endpoint of the main basket cohort is the time to first occurrence of MACE-1, defined as a composite of all-cause death and non-fatal myocardial infarction, during a follow-up period of up to 10 years. For risk-prediction analyses, 2- and 5-year time horizons will be applied.
Endpoint(s): Time to first occurrence of MACE-1 in the main basket cohort, defined as a composite of all-cause death and non-fatal myocardial infarction, during a follow-up period of up to 10 years. For risk-prediction analyses, 2- and 5-year time horizons will be applied., Time to first occurrence of MACE-2 in the main basket cohort, defined as a composite of cardiovascular death and non-fatal myocardial infarction, during a follow-up period of up to 10 years. For risk-prediction analyses, 2- and 5-year time horizons will be applied., Time to first occurrence of MACE-2 in the main basket cohort, defined as a composite of cardiovascular death and non-fatal myocardial infarction, during a follow-up period of up to 10 years. For risk-prediction analyses, 2- and 5-year time horizons will be applied., Time to first occurrence of individual cardiovascular and non-cardiovascular events in the main basket cohort during a follow-up period of up to 10 years. These events include the individual components of MACE-1 and -2, hospitalization for unstable angina, hospitalization for heart failure, and unplanned ischemia-driven revascularization (PCI/CABG), with a 90-day blanking period applied to revascularization events. For risk-prediction analyses, 2- and 5-year time horizons will be applied.

Source: https://euclinicaltrials.eu/ctis-public/view/2024-518706-41-01